EU clinical trial 2024-517009-99-00: Proof-of-concept study of Empagliflozin in patients with pulmonary arterial hypertension (EmPAH)
Protocol code: KKS-323
Sponsor: Philipps-Universitaet Marburg (Educational Institution). Phase: Therapeutic exploratory (Phase II). Countries: Germany (temporarily halted).
Therapeutic area(s): Diseases [C] - Cardiovascular Diseases [C14]
Gender: Female, Male. Age: 18-64 years, 65+ years. Enrolment: 34.
Status: Temporarily halted. Start date (EU): 2025-12-03. Decision date: 2025-08-18. Results received: No. Last updated: 2026-06-29.
Decision dates by country: DE: 2025-11-05

Condition(s): Pulmonary arterial hypertension
Product: Empagliflozin, Placebo (HPMC) capsules

Primary endpoint: Difference in the S´/RAAi ratio (measured by echocardiography) from baseline to week 4.
Endpoint(s): • Echocardiography (RA Area, TAPSE/PASP, pericardial effusion, S´/RAAi) • cMRI (RV EF, SVI, RVESVI, PA flow for impedance calculation, RV and LV EDV, RV and LV ESV, RV and LS SV, RV and LV EF, RV and LV CO, RV and LV CO, RV and LV Myocardial Mass, LVEDVI, LVESVI, LVMI, RV and LV GLS, RV and LV T1, RV and LV T2, RV and LV GLE, PA Flow and Aortic Flow) • pulmonary hemodynamics via Swan-Ganz catheterization (mPAP, dPAP, sPAP, PAWP, cardiac output by Fick (direct or indirect), PVR, SvO2, CVP/RAP, Ca, • body plethysmography • FEV1, FEV1%pred, FVC, FVCpred, TLC%pred, DLCO%pred, FVC obs.v., FEV1 obs.v., TLC obs. V., TLC%pred, RV obs. V., VC obs. V., DLCO, sRaw effektiv, • Blood gas analysis: Capillary pO2, Capillary pCO2, • Six minutes walking distance (6MWD) • BNP • CPET (VO2 and VE/VCO2 slope, as well as WHO FC), • Patient-reported outcome measures (PAH-Sympact, MLC questionnaire, EQ-5D-5L Mobility Score), • Adverse event (AE), Serious (S) AE assessment

Source: https://euclinicaltrials.eu/ctis-public/view/2024-517009-99-00